EU clinical trial 2024-520122-11-00: A PilOt dose-escalation trial with EMP16 in preparation for Phase III – the POEM trial
Protocol code: EP-005
Sponsor: Empros Pharma AB (Pharmaceutical company). Phase: Therapeutic exploratory (Phase II). Countries: Sweden (ended).
Therapeutic area(s): Diseases [C] - Nutritional and Metabolic Diseases [C18]
Gender: Female, Male. Age: 18-64 years, 65+ years. Enrolment: 39.
Status: Ended. Start date (EU): 2025-05-07. End date (EU): 2025-09-30. Decision date: 2025-04-22. Results received: Yes. Last updated: 2025-05-07.

Condition(s): Obesity
Product: Vi-Siblin S granulat, alli 60 mg hard capsules, Dietary fibre supplement Placebo - Maltodextrin

Primary endpoint: The difference in total GITE1 score between EMP16 combined with Vi-Siblin® S and conventional orlistat combined with placebo dietary fibre supplement
Endpoint(s): Presence and participant rated severity of the individual GITE components: •oily spotting •faecal incontinence (including flatulence with discharge) •diarrhoea, Presence and Investigator-rated severity of GI-related AEs. all events jointly and individually, i.e. for: •oily spotting •faecal incontinence (including flatulence with discharge) •diarrhoea

Source: https://euclinicaltrials.eu/ctis-public/view/2024-520122-11-00